EU clinical trial 2023-507995-33-00: Open label, non-randomized, Phase 1b/2 trial investigating the safety, tolerability, and antitumor activity of S095029 (anti-NKG2A antibody) as a part of combination therapy in participants with locally advanced and unresectable or metastatic MSI-H/dMMR gastro-esophageal junction/gastric cancer
Protocol code: CL1-95029-002
Sponsor: Institut De Recherches Internationales Servier IRIS (Pharmaceutical company). Phase: Phase I and Phase II (Integrated)- Other. Countries: Spain (ongoing, recruitment ended), Italy (ongoing, recruitment ended), Belgium (ongoing, recruitment ended), France (ongoing, recruitment ended), Austria (ended), Denmark (ongoing, recruitment ended), Hungary (ended).
Therapeutic area(s): Diseases [C] - Neoplasms [C04]; Diseases [C] - Digestive System Diseases [C06]
Gender: Female, Male. Age: 18-64 years, 65+ years. Enrolment: 31.
Start date (EU): 2024-05-23. Decision date: 2024-05-08. Results received: No. Last updated: 2026-03-25.
Decision dates by country: AT: 2024-05-10, HU: 2024-05-13, DK: 2024-05-08, IT: 2024-05-09, ES: 2024-05-13, FR: 2024-05-14, BE: 2024-05-13

Condition(s): MSI-H/dMMR Gastric cancer, MSI-H/dMMR Gastroesophageal-junction Cancer
Product: KEYTRUDA 25 mg/mL concentrate for solution for infusion, S095029/Sym025

Primary endpoint: Phase 1b and Phase 2: Incidence of dose-limiting toxicities (DLTs)., Phase 1b and Phase 2: Frequency and severity of adverse events (AEs) and laboratory abnormalities according to National Cancer Institute Common Terminology Criteria for Adverse Events (NCI-CTCAE v5.0)., Phase 1b and Phase 2: Incidence of AEs leading to dose interruption, modification, delays and permanent treatment discontinuation., Phase 1b and Phase 2: Change from baseline to the end of the study in safety laboratory values and vital signs., Phase 2: Objective response (OR) per investigator assessment using RECIST v1.1.
Endpoint(s): Phase 1b: Objective response (OR), duration of response (DoR), progression-free survival (PFS), and disease control (DC) according to RECIST v1.1 and iRECIST as assessed by investigator., Phase 1b and Phase 2: Overall survival (OS) per investigator assessment., Phase 1b and Phase 2: Serum concentrations of S095029, Phase 1b and Phase 2: Concentration of potential antibodies directed against S095029., Phase 2: DoR, PFS, and DC according to RECIST v1.1 as assessed by investigator., Phase 2: OR, DoR, PFS, and DC according to iRECIST criteria as per investigator assessment.

Source: https://euclinicaltrials.eu/ctis-public/view/2023-507995-33-00